EU clinical trial 2024-512749-18-00: Isa-RVD Study: Phase II, Multi-centre, Single-Arm, Open-Label Study to evaluate the efficacy and safety of the combination regimen Isatuximab, Lenalidomide, Bortezomib, and Dexamethasone in Patients with Newly Diagnosed Multiple Myeloma
Protocol code: CTRIAL-IE 19-34
Sponsor: Cancer Trials Ireland (Patient organisation/association). Phase: Therapeutic exploratory (Phase II). Countries: Ireland (ongoing, recruitment ended), Denmark (ongoing, recruitment ended).
Therapeutic area(s): Diseases [C] - Neoplasms [C04]
Gender: Female, Male. Age: 18-64 years, 65+ years. Enrolment: 52.
Status: Ongoing, recruitment ended. Start date (EU): 2022-03-03. Decision date: 2024-09-04. Results received: No. Last updated: 2026-05-18.
Decision dates by country: IE: 2024-09-04, DK: 2024-09-10

Condition(s): Newly diagnosed Multiple Myeloma
Product: Revlimid 25 mg hard capsules, Isatuximab, Dexamethasone Tablets 2 mg, Revlimid 15 mg hard capsules, Isatuximab, VELCADE 1 mg powder for solution for injection, Revlimid 10 mg hard capsules

Primary endpoint: VGPR or better rate at the end of two cycles of induction treatment, defined as the proportion of patients who have achieved VGPR or better, according IMWG criteria (Kumar et al. 2016), at the end of two cycles of induction treatment.
Endpoint(s): CR and sCR rate after one year and two years of maintenance therapy., ORR and rate of VGPR or better following one year of maintenance therapy. ORR will be defined as achieving a partial response or better., Time to VGPR or better., Negative MRD rate following induction, ASCT and after 1 and 2 years of maintenance treatment., Clinical outcomes including: TTP, PFS, OS, DOR., Safety and tolerability of Isa-RVD., Stem cell yield after mobilization., CR and sCR rate following induction, ASCT and maintenance treatment in the subgroup of non-IgG kappa positive patients., Duration of and time to sCR and time to CR in the subgroup of non-IgG kappa positive patients., Clinical efficacy in high-risk cytogenetic subgroups: del(1p), gain of 1q, del(17p), t(4;14), t(14;16), t(14;20)., Immune profiling (NK, T, and B cells) and T-cell receptor sequencing., MRD detection performed by flow cytometry and NGS., Immunogenicity of Isatuximab., PROs., Stem cell yield after mobilization (number of CD34+ cells)

Source: https://euclinicaltrials.eu/ctis-public/view/2024-512749-18-00